EU clinical trial 2024-518318-25-00: HELIOS-B: A Phase 3, Randomized, Double-blind, Placebo-controlled, Multicenter Study to Evaluate the Efficacy and Safety of Vutrisiran in Patients with Transthyretin Amyloidosis with Cardiomyopathy (ATTR Amyloidosis with Cardiomyopathy)
Protocol code: ALN-TTRSC02-003
Sponsor: Alnylam Pharmaceuticals Inc. (Pharmaceutical company). Phase: Therapeutic confirmatory (Phase III). Countries: Ireland (ended), Portugal (ended), Denmark (ended), Czechia (ended), Lithuania (ended), Germany (ongoing, recruitment ended), Spain (ended), Hungary (ended), Netherlands (ended), Sweden (ongoing, recruitment ended), Belgium (ended), Norway (ended), Poland (ended), Austria (ended), France (ended), Croatia (ended).
Therapeutic area(s): Diseases [C] - Cardiovascular Diseases [C14]
Gender: Female, Male. Age: 18-64 years, 65+ years. Enrolment: 441.
Start date (EU): 2020-06-24. Decision date: 2024-11-18. Results received: No. Last updated: 2026-06-26.
Decision dates by country: HR: 2024-12-03, SE: 2024-11-18, PL: 2024-11-24, DK: 2024-11-19, ES: 2024-11-19, IE: 2024-11-18, NL: 2024-11-21, DE: 2024-11-22, AT: 2024-11-25, LT: 2024-11-20, BE: 2024-11-19, HU: 2024-11-20, PT: 2024-11-18, NO: 2024-11-22, CZ: 2024-11-20, FR: 2024-11-19

Condition(s): Transthyretin Amyloidosis with Cardiomyopathy (ATTR Amyloidosis with Cardiomyopathy)
Product: 0.9% Sodium chloride, Amvuttra 25 mg solution for injection in pre-filled syringe

Primary endpoint: Composite outcome of all-cause mortality and recurrent CV events (CV hospitalizations and urgent heart failure [HF] visits) in both the overall population and the vutrisiran monotherapy subgroup (defined as patients not on tafamidis at study baseline).
Endpoint(s): The following secondary endpoints will be defined in both the overall population and the vutrisiran monotherapy subgroup: - Change from baseline in 6-minute walk test (6-MWT) - Change from baseline in the Kansas City Cardiomyopathy QuestionnaireOverall Summary (KCCQ-OS) - All-cause mortality - Change from baseline in NYHA Class

Source: https://euclinicaltrials.eu/ctis-public/view/2024-518318-25-00